EU clinical trial 2024-518588-36-00: A Double-Blind, Randomized, Active Controlled, Parallel-group, Phase 1/3 Study to Compare Pharmacokinetics, Efficacy and Safety of Subcutaneous CT-P44 and Darzalex Faspro in Combination with Lenalidomide and Dexamethasone in Patients with Refractory or Relapsed Multiple Myeloma
Protocol code: CT-P44 3.1
Sponsor: Celltrion Inc. (Pharmaceutical company). Phase: Therapeutic confirmatory (Phase III). Countries: Spain (authorised, recruiting), Poland (ongoing, recruiting).
Therapeutic area(s): Diseases [C] - Neoplasms [C04]
Gender: Female, Male. Age: 18-64 years, 65+ years. Enrolment: 42.
Start date (EU): 2025-12-24. Decision date: 2025-08-29. Results received: No. Last updated: 2026-05-05.
Decision dates by country: ES: 2025-08-29, PL: 2025-09-12

Condition(s): Refractory or Relapsed Multiple Myeloma
Product: Daratumumab, DARATUMUMAB, LENALIDOMIDE, DEXAMETHASONE SODIUM PHOSPHATE, DEXAMETHASONE

Primary endpoint: AUCWeek0-1 and AUCWeek8-10 of daratumumab in the PK set–PK Group at 1st dose, and PK set–PK Group up to 9th doses, respectively., Very good partial response (VGPR) or better based on the confirmed best overall response (BOR) up to Week 24 from the last patient’s randomization according to the IMWG criteria in the intent-to-treat (ITT) set.

Source: https://euclinicaltrials.eu/ctis-public/view/2024-518588-36-00